EU clinical trial 2023-506570-12-01: An adaptive, randomized, placebo-controlled, double-blind study to evaluate the safety and efficacy of RL-007 in the treatment of cognitive impairment associated with schizophrenia (CIAS)
Protocol code: C07-03-02
Sponsor: Recognify Life Sciences Inc. (Pharmaceutical company). Phase: Therapeutic exploratory (Phase II). Countries: Poland (ended), Bulgaria (ended), Czechia (ended).
Therapeutic area(s): Psychiatry and Psychology [F] - Mental Disorders [F03]
Gender: Female, Male. Age: 18-64 years. Enrolment: 164.
Status: Ended. Start date (EU): 2024-06-13. End date (EU): 2025-04-23. End date: 2025-04-24. Decision date: 2024-05-23. Results received: Yes. Last updated: 2025-04-22.
Decision dates by country: BG: 2024-05-28, CZ: 2024-05-23, PL: 2024-05-27

Condition(s): Cognitive disorder, Schizophrenia
Product: Placebo to RL-007, RL-007

Primary endpoint: Change from baseline to Week 6 in: The MATRICS Consensus Cognitive Battery (MCCB) neurocognitive composite score
Endpoint(s): Change from baseline to Week 6 in: • The Symbol Coding task from the MCCB •The Speed of Processing domain of the MCCB • The Attention/Vigilance domain of the MCCB • The Working Memory domain of the MCCB • The Verbal Memory domain of the MCCB • The Visual Learning domain of the MCCB • The Reasoning and Problem solving domain of the MCCB • Clinical Global Impression – Severity (CGI-S), TEAEs: From the randomization visit through the final follow up assessment on Week 8., Vital signs (blood pressure, heart rate [HR], respiratory rate, and temperature): Randomization (baseline), and Weeks 3 and 6., Physical examinations: Randomization (baseline) and Weeks 3 and 6., ECGs: Screening (baseline) and Week 6., Clinical laboratory tests [hematology, serum chemistry and urinalysis]: Randomization (baseline) and Week 6., C-SSRS: Randomization (baseline) and Weeks 3 and 6., Change from baseline in the Virtual Reality Functional Capacity Assessment Tool (VRFCAT) at Week 6, The Social Cognition domain of the MCCB

Source: https://euclinicaltrials.eu/ctis-public/view/2023-506570-12-01